EU clinical trial 2022-503026-12-00: Efficacy and safety of infliximab for immune checkpoint inhibitor induced colitis: a multinational, randomised, open label, phase III trial - The iCaD Study
Sponsor: Odense University Hospital (Hospital/Clinic/Other health care facility). Phase: Therapeutic confirmatory (Phase III). Countries: Denmark (ongoing, recruiting).
Therapeutic area(s): Diseases [C] - Neoplasms [C04]; Diseases [C] - Digestive System Diseases [C06]
Gender: Female, Male. Age: 18-64 years, 65+ years. Enrolment: 120.
Status: Ongoing, recruiting. Start date (EU): 2023-08-22. Decision date: 2023-05-04. Results received: No. Last updated: 2025-10-24.

Condition(s): Immune checkpoint inhibitor related colitis
Product: PREDNISOLONE, PREDNISOLONE, METHYLPREDNISOLONE, INFLIXIMAB

Primary endpoint: Time (days) to persistent modified CTCAE (mCTCAE; definition according to Table 3) grade ≤ 1 ir-colitis/diarrhoea. Persistent is defined as grade ≤ 1 ir-colitis/diarrhoea for five consecutive days or more with no increase in corticosteroid intake, and the event will be calculated from the first day of grade ≤ 1 ir-colitis/diarrhoea of that period (time frame: seven weeks)
Endpoint(s): Proportion of study subjects with grade ≤ 1 ir-colitis/diarrhoea at 72 hours (time frame: 72 hours), Proportion of study subjects with persistent grade ≤ 1 ir-colitis/diarrhoea at three weeks. Persistent is defined as grade ≤ 1 ir-colitis/diarrhoea for five consecutive days or more, and the event will be calculated from the first day of grade ≤ 1 ir-colitis/diarrhoea of that period (time frame: three weeks), Proportion of study subjects with a corticosteroid-free clinical remission (grade ≤ 1 ir-colitis/diarrhoea) after seven weeks (time frame: seven weeks), Proportion of study subjects requiring rescue immunosuppressive medication; Arm A (initial corticosteroid only): infliximab if no improvement to grade ≤ 2 ir-colitis/diarrhoea after 3 days (time frame: seven weeks); Arm B (initial infliximab): second dose infliximab according to physicians decision if no improvement to grade ≤ 2 ir-colitis/diarrhoea after seven days, Cumulative corticosteroid exposure (time frame: seven weeks), QoL by means of EORTC-QLQ-C30 questionnaire and selected PRO-CTCAE items at baseline, 3, 12, 24, and 52 weeks after randomisation (time frame: 52 weeks), Proportion of study subjects with treatment related adverse events as assessed by CTCAE v5.0 (time frame: 12 weeks), Proportion of study subjects with colectomy or colitis-specific mortality (time frame: seven weeks), Proportion of study subjects with recurrence of ir-colitis/diarrhoea on subsequent reintroduction of ICI, Subgroup analyses stratified for ipilimumab containing ICI for time (days) to persistent grade ≤ 1 ir-colitis/diarrhoea. Persistent is defined as grade ≤ 1 ir-colitis/diarrhoea for five consecutive days or more, and the event will be calculated from the first day of grade ≤ 1 ir-colitis/diarrhoea of that period (time frame: seven weeks), Progression Free Survival stratified by cancer type (time frame: duration of time from start of randomisation to time of progression or death, whichever occurs first or up to 24 months), Overall Survival stratified by cancer type (time frame: the duration of time from start of randomisation to time of death or up to 24 months), Translational research projects to explore the diversity and evolution of the immunologic cells and faecal microbiome from initiation of immune checkpoint inhibition, to the event of ir-colitis/diarrhoea, and to resolution after immunosuppressive therapy

Source: https://euclinicaltrials.eu/ctis-public/view/2022-503026-12-00